EU clinical trial 2024-516137-13-00: Randomised phase 3 trial of enzalutamide in first line androgen deprivation therapy for metastatic prostate cancer: ENZAMET
Protocol code: CTRIAL-IE 14-06
Sponsor: Cancer Trials Ireland (Patient organisation/association). Phase: Therapeutic confirmatory (Phase III). Countries: Ireland (ongoing, recruitment ended).
Therapeutic area(s): Diseases [C] - Neoplasms [C04]
Gender: Male. Age: 18-64 years, 65+ years. Enrolment: 82.
Status: Ongoing, recruitment ended. Start date (EU): 2014-12-18. Decision date: 2024-10-08. Results received: No. Last updated: 2026-06-10.

Condition(s): Metastatic Prostate Cancer
Product: Flutamide 250 mg Tablets, Xtandi - 40 mg soft capsules, Casodex® 50 mg Film-coated Tablets

Primary endpoint: Overall survival (death from any cause)
Endpoint(s): Prostate specific antigen progression free survival (PCGW2), Clinical progression free survival (imaging, symptoms, signs), Adverse events (CTCAE v4.03), Health related quality of life (EORTC QLQ C-30, PR-25 and EQ-5D-5L), Health outcomes relative to costs (incremental cost effectiveness ratio)

Source: https://euclinicaltrials.eu/ctis-public/view/2024-516137-13-00